EU clinical trial 2025-521378-33-00: Impact of Patiromer treatment on dietary Potassium intake restriction and health-related quality of life and nutrition in patients on Chronic Dialysis Therapy: a Double-Blind, Prospective, Randomized, Placebo-Controlled, Pilot Trial
Protocol code: PRINCE
Sponsor: Istituto Di Ricerche Farmacologiche Mario Negri (Laboratory/Research/Testing facility). Phase: Therapeutic confirmatory (Phase III). Countries: Italy (ongoing, recruiting).
Therapeutic area(s): Diseases [C] - Nutritional and Metabolic Diseases [C18]
Gender: Female, Male. Age: 18-64 years, 65+ years. Enrolment: 40.
Status: Ongoing, recruiting. Start date (EU): 2025-07-31. Decision date: 2025-07-08. Results received: No. Last updated: 2026-05-08.

Condition(s): End Stage Kidney Disease on chronic dialysis therapy
Product: Veltassa 8.4 g powder for oral suspension, Placebo

Primary endpoint: Proportion of participants with low-potassium diet withdrawal and/or down-titration at completion of the treatment period compared to diet at inclusion
Endpoint(s): Proportion of participants with low potassium diet withdrawal at completion of the treatment period, considered as a single endpoint, Reduction in dietary restriction considered as a continuous variable as assessed by a dietary score (to be defined): 0 = No restriction; 1 = Moderate restriction; 2 = Strict restriction, Changes in pre-dialysis serum potassium level considered as a continuous variable, Reduced need for rescue therapy with potassium binding resins such as Sodium polystyrene sulfonate (SPS, Kayexalate®, Sanofi-Aventis S.p.A) or supplementary dialysis sessions to treat intercurrent hyperkalemia, Introduction or optimization of RAS inhibitor therapy to control arterial blood pressure or heart failure and/or prevent cardiovascular events without increasing the risk of hyperkalemia, Proportion of patients with cardiac arrhythmias or other symptoms (muscle weakness, fatigue, hand of feet numbness or tingling, vomiting, flaccid paralysis and others) potentially related to hyperkalemia, Proportion of patients with hypokalemia (serum potassium <3.5 mEq/L) and/or of cardiac arrhythmias potentially related to hypokalemia, Participant’s quality of life change from baseline at the end of the intervention, measured using the Italian translation of the Kidney Disease Quality of Life Instrument (KDQOL) Version 1.31 and the standard SF-36 quality of life questionnaire Italian Version 1.6

Source: https://euclinicaltrials.eu/ctis-public/view/2025-521378-33-00